EU clinical trial 2022-500954-40-00: A Four Way Crossover Thorough QT/QTc Study to Evaluate the Electrocardiographic Effects of Therapeutic and Supratherapeutic Doses of Cytisinicline in Healthy Smokers
Protocol code: ACH-CYT-06
Sponsor: Achieve Life Sciences Inc. (Pharmaceutical company). Phase: Human Pharmacology (Phase I)- Other. Countries: Portugal (ended).
Therapeutic area(s): Psychiatry and Psychology [F] - Behavioral Disciplines and Activities [F04]
Gender: Female, Male. Age: 18-64 years. Enrolment: 32.
Status: Ended. Start date (EU): 2022-10-17. End date (EU): 2023-01-06. Decision date: 2022-10-03. Results received: Yes. Last updated: 2022-10-03.

Condition(s): Nicotine addiction
Product: Cytisinicline Placebo, Avelox 400 mg comprimidos revestidos por película, Cytisinicline

Primary endpoint: Concentration effect modeling: change from baseline in QTc, corrected for HR based on the Fridericia QT correction method (ΔQTcF) compared with matched timepoint cytisinicline concentration. This is used to calculate a predicted placebo-adjusted change from baseline in the QTcF interval (ΔΔQTcF). In the event of an effect on HR of ≥10 bpm, the individual QT correction method (QTcI) will be utilized as the primary QT correction method.
Endpoint(s): Time-point change from baseline in QTc, placebo-adjusted and corrected for HR based on the Fridericia QT correction (QTcF) method (ΔΔQTcF). In the event of an effect on HR of ≥10 bpm, the individual QT correction method (QTcI) will be utilized as the primary QT correction method., Time-point change from baseline, placebo-adjusted, for HR, PR interval (PR), and QRS duration (QRS)., Evaluation of the relationship between the plasma concentration of cytisinicline and the placebo-adjusted change from baseline in HR, PR, and QRS, Evaluation of the effects of cytisinicline on ECG morphology (including T wave and U wave)., Central tendency and categorical outlier analyses based on uncorrected QT, PR, QRS, and HR.

Source: https://euclinicaltrials.eu/ctis-public/view/2022-500954-40-00